EU clinical trial 2023-503968-16-00: (22424) Exploratory, randomized, non-blinded, crossover study to investigate the relative bioavailability of different elinzanetant soft gel capsules in healthy participants
Protocol code: 22424
Sponsor: Bayer Consumer Care AG, Bayer AG (Pharmaceutical company). Phase: Human Pharmacology (Phase I)- Other. Countries: Germany (ended).
Therapeutic area(s): Diseases [C] - Hormonal diseases [C19]
Gender: Female, Male. Age: 18-64 years. Enrolment: 16.
Status: Ended. Start date (EU): 2023-09-25. End date (EU): 2023-11-27. Decision date: 2023-07-14. Results received: Yes. Last updated: 2023-10-06.

Condition(s): Vasomotor symptoms as a sex hormone-dependent disorder in women and men
Product: Elinzanetant Bayer, BAY 3427080, Elinzanetant Bayer

Primary endpoint: Area under the concentration vs. time curve from zero to infinity after single (first) dose (AUC)* after single dose under fasted condition *Area under the concentration vs. time curve from zero to last quantifiable concentration (AUC(0-tlast)) will be used as main parameter if AUC cannot be calculated reliably in all participants, Maximum observed concentration (Cmax) after single dose under fasted condition
Endpoint(s): Number of participants with treatment-emergent adverse events and severity of treatment-emergent adverse events

Source: https://euclinicaltrials.eu/ctis-public/view/2023-503968-16-00